EU clinical trial 2024-518639-12-00: REVOLUTION; Randomized controlled trial comparing immediate versus extended release tacrolimus; reducing calcineurin inhibitor related toxicity in lung transplantation patients
Sponsor: Universitair Medisch Centrum Groningen (Hospital/Clinic/Other health care facility). Phase: Therapeutic confirmatory (Phase III). Countries: Netherlands (ended).
Therapeutic area(s): Diseases [C] - Respiratory Tract Diseases [C08]
Gender: Female, Male. Age: 18-64 years, 65+ years. Enrolment: 140.
Status: Ended. Start date (EU): 2025-01-28. End date (EU): 2025-06-12. Decision date: 2025-01-28. Results received: No. Last updated: 2025-01-28.

Condition(s): lung transplantation
Product: PROGRAF 1 mg capsule, Envarsus 0.75 mg prolonged-release tablets

Primary endpoint: Kidney function

Source: https://euclinicaltrials.eu/ctis-public/view/2024-518639-12-00